EU clinical trial 2024-513912-89-00: A Phase 2/3 Randomized, Controlled, Open-Label Study of KRT 232 in Subjects with Primary Myelofibrosis (PMF), Post Polycythemia Vera MF (Post-PV-MF), Or Post Essential Thrombocythemia MF (Post-ET-MF) who are Relapsed or Refractory to Janus Kinase (JAK) Inhibitor Treatment
Protocol code: KRT-232-101
Sponsor: Kartos Therapeutics Inc. (Pharmaceutical company). Phase: Phase II and Phase III (Integrated). Countries: Germany (ongoing, recruitment ended), Czechia (ongoing, recruitment ended), Spain (ongoing, recruitment ended), Poland (ongoing, recruitment ended), Italy (ongoing, recruitment ended), Croatia (ongoing, recruitment ended), France (ongoing, recruitment ended), Bulgaria (ongoing, recruitment ended), Lithuania (ongoing, recruitment ended), Hungary (ongoing, recruitment ended), Romania (ongoing, recruitment ended), Greece (ended), Portugal (ended).
Therapeutic area(s): Diseases [C] - Neoplasms [C04]
Gender: Female, Male. Age: 18-64 years, 65+ years. Enrolment: 253.
Start date (EU): 2018-12-13. Decision date: 2024-11-14. Results received: No. Last updated: 2025-09-17.
Decision dates by country: PT: 2024-11-14, RO: 2024-11-18, BG: 2024-11-15, ES: 2024-11-18, IT: 2024-11-18, CZ: 2024-11-14, GR: 2025-01-23, DE: 2024-11-14, PL: 2024-12-09, LT: 2024-11-14, FR: 2024-11-20, HU: 2024-11-15, HR: 2024-12-09

Condition(s): Primary Or Secondary (Post-PV MF or Post-ET-MF) Myelofibrosis (MF) With Intermediate Or High-Risk TP53 Wild-Type (TP53 WT) Who Are Relapsed Or Refractory to Janus Kinase (JAK) - Inhibitor Treatment
Product: Danatrol 50 mg capsule rigide, Navtemadlin 25-15, Navtemadlin 25-30, Navtemadlin 10-15, Navtemadlin 10-60, Navtemadlin 25-120, Prednison 10 mg GALEN®, DANAZOL POLFARMEX, 200 mg, tabletki, HYDREA 500 mg capsule, Lenalidomide Accord 5 mg hard capsules, Pegasys 180 micrograms solution for injection in pre-filled syringe, Navtemadlin 25-60

Primary endpoint: Part A: The proportion of subjects achieving a ≥35% spleen volume reduction from Baseline to Week 24, as assessed by magnetic resonance imaging (MRI) or computed tomography (CT) scan., Part B: The proportion of subjects in each arm achieving SVR of ≥ 35% at Week 24 by MRI/CT scan (central review)
Endpoint(s): Part A: Proportion of subjects with a reduction in total symptom score, Part A: To determine the duration of reduction of spleen volume, Part A: To determine the need for red blood cell (RBC) transfusion, Part A: The proportion of subjects who have RBC transfusion independence at week 24, Part A: To determine complete and partial remission of treated subjects, Part A: To determine time to death from any cause in treated subjects, Part A: To determine the pharmacokinetic/pharmacodynamic (PK/PD) profile of KRT-232, Part B: The proportion of subjects with reduction from Baseline to Week 24 in the total symptom score, Part B: Time from randomization to death from any cause, Part B: Progression free survival (PFS): time from randomization to either first occurrence of disease progression or death due to any cause, Part B: The proportion of subjects in each arm achieving spleen volume reduction, Part B: Time from initial spleen volume reduction until the first occurrence of disease progression, Part B: The proportion of subjects who have red blood cell transfusion independence at week 24

Source: https://euclinicaltrials.eu/ctis-public/view/2024-513912-89-00